EU clinical trial 2024-514773-22-00: A French multicenter Phase 4 open label extension study of long-term safety and efficacy in patients with Pompe disease who previously participated in avalglucosidase development studies in France
Protocol code: PTA17333
Sponsor: Sanofi Winthrop Industrie (Pharmaceutical company). Phase: Therapeutic use (Phase IV). Countries: France (ongoing, recruitment ended).
Therapeutic area(s): Diseases [C] - Congenital, Hereditary, and Neonatal Diseases and Abnormalities [C16]
Gender: Female, Male. Age: 0-17 years, 18-64 years, 65+ years. Enrolment: 17.
Status: Ongoing, recruitment ended. Start date (EU): 2022-07-11. Decision date: 2024-08-06. Results received: No. Last updated: 2026-07-29.

Condition(s): Glycogen storage disease type II
Product: Nexviadyme 100 mg powder for concentrate for solution for infusion, Nexviadyme 100 mg powder for concentrate for solution for infusion, Nexviadyme 100 mg powder for concentrate for solution for infusion, Nexviadyme 100 mg powder for concentrate for solution for infusion

Primary endpoint: Number of adverse events (AE), treatment-emergent adverse events (TEAE), including infusion associated reactions (IAR) and death
Endpoint(s): Assessment of six-minute walk test (distance in meters and % predicted value) for late-onset Pompe disease (LOPD) and infantile-onset Pompe disease (IOPD) participants, Assessment of quick motor function test (QMFT) for LOPD participants, Pulmonary function tests (forced vital capacity [FVC] (% predicted), maximum expiratory pressure/maximum inspiratory pressure) in upright and supine positions for LOPD and IOPD participants, Quality of life evaluation: 12-item short form health survey (SF-12) for LOPD participants, Quality of life evaluation: Pompe Disease Symptom Scale (PDSS) for LOPD participants, Quality of life evaluation: Pompe Disease Impact Scale (PDIS) for LOPD participants, Pompe Pediatric Evaluation of Disability Inventory (Pompe-PEDI) score for IOPD participants, PedsQL score for IOPD participants, Left Ventricular Mass Index (LVMI) Z-score in IOPD participants

Source: https://euclinicaltrials.eu/ctis-public/view/2024-514773-22-00